EU clinical trial 2025-521398-15-00: A randomized, Phase 3, double-blind, 52-week study to evaluate the efficacy and safety of rilzabrutinib (SAR444671) compared to placebo in adult participants with active IgG4-related disease
Protocol code: EFC17359
Sponsor: Sanofi-Aventis Recherche & Developpement (Pharmaceutical company). Phase: Therapeutic confirmatory (Phase III). Countries: Netherlands (ongoing, recruiting), Spain (ongoing, recruiting), France (ongoing, recruiting), Belgium (authorised, recruitment pending), Sweden (authorised, recruitment pending), Germany (ongoing, recruiting), Poland (ongoing, recruiting), Italy (ongoing, recruiting).
Therapeutic area(s): Diseases [C] - Immune System Diseases [C20]
Gender: Female, Male. Age: 18-64 years, 65+ years. Enrolment: 50.
Start date (EU): 2025-12-04. Decision date: 2025-10-24. Results received: No. Last updated: 2026-06-02.
Decision dates by country: NL: 2025-10-27, ES: 2025-10-30, IT: 2025-11-07, SE: 2025-11-07, FR: 2025-10-24, BE: 2025-10-24, DE: 2025-11-07, PL: 2025-11-07

Condition(s): Immune system diseases

Primary endpoint: Time to first adjudicated clinical disease flare treated by the investigator during the Blinded Treatment period
Endpoint(s): Percentage of participants without IgG4-RD adjudicated clinical disease flare and off glucocorticoids and immunomodulators, Percentage of participants without IgG4-RD adjudicated clinical disease flare and off glucocorticoids, Annualized rate of clinical disease flares, Change in IgG4-RD RI total activity scores from baseline to Week 52, Percent change in IgG4-RD RI total activity scores form baseline to Week 52, Change in IgG4-RD RI total activity scores from baseline to Week 12, Proportion of participants with reduction of ≥2 points from the baseline IgG4-RD RI total activity score, Proportion of participants in complete remission, Cumulative glucocorticoid dose for treatment of IgG4-RD, Proportion of participants with potentially clinically significant abnormalities in laboratory tests, vital signs, and electrocardiograms in the Safety Population, Proportion of participants with TEAEs, AESIs, SAEs in the Safety Population

Source: https://euclinicaltrials.eu/ctis-public/view/2025-521398-15-00